EU clinical trial 2023-508201-25-00: MICROBIOTA MODIFICATION FOR IMMUNO-ONCOLOGY IN HEPATOCELLULAR CARCINOMA - “MOTHER”
Protocol code: 2023-1-69-001
Sponsor: Centre De Lutte Contre Le Cancer Eugene Marquis (Hospital/Clinic/Other health care facility). Phase: Therapeutic exploratory (Phase II). Countries: France (ongoing, recruiting).
Therapeutic area(s): Diseases [C] - Neoplasms [C04]
Gender: Female, Male. Age: 18-64 years, 65+ years. Enrolment: 80.
Status: Ongoing, recruiting. Start date (EU): 2025-03-12. Decision date: 2024-05-28. Results received: No. Last updated: 2026-07-16.

Condition(s): Hepatocellular carcinoma
Product: Avastin 25 mg/ml concentrate for solution for infusion., Avastin 25 mg/ml concentrate for solution for infusion., Tecentriq 840 mg concentrate for solution for infusion, Tecentriq 1,200 mg concentrate for solution for infusion, IMFINZI 50 mg/mL concentrate for solution for infusion., EXL01, IMJUDO 20 mg/ml concentrate for solution for infusion.

Primary endpoint: The Objective Response Rate at W12, defined as the proportion of patients with a Complete objective tumor Response (CR) or a Partial objective tumor Response (PR) from inclusion to week 12. The objective tumor response is defined as the best overall tumor response (BOR) observed in a patient within all-time points between inclusion to the W12 visit, according to the RECIST 1.1., The overall tumor response observed at first imaging after 2 cycles of standard of care immunotherapy (W6 for patients treated with atezolizumab-bevacizumab cohort or W8 for patients treated with durvalumab- tremelimumab cohort), W12, M6, M12 according to the mRECIST, RECIST 1.1 and iRECIST criteria., The ORR at W12, according to the mRECIST, and iRECIST criteria., The Disease control rate (DCR), as the proportion of patients with BOR as CR, PR or stable disease (SD) defined according to the mRECIST, RECIST 1.1 and iRECIST criteria at W12, M6, M12., The Progression-Free Survival, defined as the time from patient inclusion to progression or death from any cause., The Overall Survival, defined as the time from patient inclusion to death from any cause., The ORR at M6, M12, according to the mRECIST, RECIST 1.1 and iRECIST criteria.
Endpoint(s): Frequency of adverse events, graded according to the last up-to-date NCI-CTCAE classification. Adverse events are monitored from inclusion to 30 days after the last EXL01 intake.

Source: https://euclinicaltrials.eu/ctis-public/view/2023-508201-25-00